EU clinical trial 2022-502419-12-00: First-in-Human, Open-label, Dose-Escalation Trial with Expansion Cohorts to Evaluate the Safety of GEN1053 as Monotherapy and in Combination With an Immunomodulator in Subjects with Malignant Solid Tumors
Protocol code: GCT1053-01
Sponsor: Genmab B.V. (Pharmaceutical company). Phase: Phase I and Phase II (Integrated)- First administration to humans. Countries: Spain (ended).
Therapeutic area(s): Diseases [C] - Neoplasms [C04]
Gender: Female, Male. Age: 18-64 years, 65+ years. Enrolment: 86.
Status: Ended. Start date (EU): 2022-11-02. End date (EU): 2024-05-23. End date: 2024-05-24. Decision date: 2023-01-30. Results received: Yes. Last updated: 2024-07-02.

Condition(s): Malignant Solid Tumors
Product: HexaBody-CD27

Primary endpoint: Dose-limiting toxicities (DLTs; Dose Escalation parts only), Adverse events (AEs) and safety laboratory parameters
Endpoint(s): PK parameters: clearance, volume of distribution, maximum concentration, time of Cmax, predose trough concentrations, half-life, area under the concentration-time curve, Antidrug antibody response of GEN1053 and in combination with IM, Antitumor activity according to Response Evaluation Criteria in Solid Tumors (RECIST) 1.1: objective response rate (ORR), disease control rate (DCR), duration of response (DoR)

Source: https://euclinicaltrials.eu/ctis-public/view/2022-502419-12-00